EU clinical trial 2022-502365-26-00: A double-dummy, double-blind, randomized, active controlled, two-way cross-over study with 12-week treatment duration per period, to evaluate the efficacy and safety of QVM149 (indacaterol acetate / glycopyrronium bromide / mometasone furoate) compared to salmeterol xinafoate/fluticasone propionate in children from 12 years to less than 18 years of age with asthma.
Protocol code: CQVM149C2301
Sponsor: Novartis Pharma AG (Pharmaceutical company). Phase: Therapeutic confirmatory (Phase III). Countries: Poland (authorised, recruitment pending), France (authorised, recruitment pending), Slovakia (authorised, recruitment pending), Spain (authorised, recruitment pending), Hungary (authorised, recruitment pending), Germany (authorised, recruitment pending), Romania (authorised, recruitment pending).
Therapeutic area(s): Diseases [C] - Respiratory Tract Diseases [C08]
Gender: Female, Male. Age: 0-17 years. Enrolment: 68.
Status: Authorised, recruitment pending. Decision date: 2026-06-01. Results received: No. Last updated: 2026-08-04.
Decision dates by country: FR: 2026-06-03, DE: 2026-06-02, HU: 2026-06-04, RO: 2026-06-08, ES: 2026-06-02, PL: 2026-06-05, SK: 2026-06-01

Condition(s): Asthma
Product: AirFluSal Forspiro 50 microgram/500 microgram per actuation inhalation powder, pre-dispensed, Seretide Accuhaler 50 microgram/250 microgram/ dose inhalation powder, predispensed., Ventolin Evohaler 100 micrograms Pressurised Inhalation Suspension, Placebo for Salmeterol xinafoate/ fluticasone propionate, QVM149, Placebo to QVM149

Primary endpoint: ● Change from baseline in trough FEV1 at Week 12 of each treatment period.
Endpoint(s): ● Change from baseline in (ACQ-5) score at Week 12 of each treatment period ● Change from baseline in (PAQLQ) total score at Week 12 of each treatment period ● Change from baseline in average rescue medication use (daily, daytime, and night-time) over 12 weeks of each treatment period ● Number and severity of reported asthma exacerbations over 12 weeks of each treatment period, Safety assessments including incidence of adverse events, serum cortisol, blood glucose, serum potassium, electrocardiography, local side effects of ICS

Source: https://euclinicaltrials.eu/ctis-public/view/2022-502365-26-00